EU clinical trial 2025-522867-13-00: A Phase 2 Study to Investigate the Safety and Efficacy of Petosemtamab in Adults with Non-Small Cell Lung Cancer in Combination with Pembrolizumab.
Protocol code: MCLA-158-CL04
Sponsor: Merus B.V. (Pharmaceutical company). Phase: Therapeutic exploratory (Phase II). Countries: Spain (ended), Belgium (ended), Netherlands (ended), Poland (not authorised), Italy (ended), France (ended).
Therapeutic area(s): Not possible to specify
Gender: Female, Male. Age: 18-64 years, 65+ years. Enrolment: 90.
Status: Ended. Start date (EU): 2026-04-27. End date (EU): 2026-06-09. End date: 2026-06-10. Decision date: 2026-04-09. Results received: No. Last updated: 2026-05-01.
Decision dates by country: BE: 2026-04-09, FR: 2026-04-13, IT: 2026-04-09, ES: 2026-04-09, NL: 2026-04-13, PL: 2026-04-13

Condition(s): Non Small Cell Lung Cancer
Product: KEYTRUDA 25 mg/mL concentrate for solution for infusion.

Primary endpoint: ORR per Investigator assessment using RECIST 1.1
Endpoint(s): DoR per Investigator assessment using RECIST 1.1 • DCR per Investigator assessment using RECIST 1.1 • CBR per Investigator assessment using RECIST 1.1 • PFS per Investigator assessment using RECIST 1.1 • OS, • AEs • Clinical laboratory data, Integrated analysis using population PK model approach, Please refer to Protocol for further secondary end points

Source: https://euclinicaltrials.eu/ctis-public/view/2025-522867-13-00